EU clinical trial 2023-506576-27-00: A Phase 3, Randomized Study of Amivantamab and Lazertinib Combination Therapy Versus Osimertinib Versus Lazertinib as First-Line Treatment in Patients with EGFR-Mutated Locally Advanced or Metastatic Non-Small Cell Lung Cancer
Protocol code: 73841937NSC3003
Sponsor: Janssen - Cilag International (Pharmaceutical company). Phase: Therapeutic confirmatory (Phase III). Countries: Belgium (ongoing, recruitment ended), France (ongoing, recruitment ended), Italy (ongoing, recruitment ended), Spain (ongoing, recruitment ended), Poland (ongoing, recruitment ended), Netherlands (ended), Portugal (ongoing, recruitment ended), Hungary (ended), Germany (ongoing, recruitment ended).
Therapeutic area(s): Diseases [C] - Neoplasms [C04]
Gender: Female, Male. Age: 18-64 years, 65+ years. Enrolment: 170.
Start date (EU): 2020-09-30. Decision date: 2024-06-12. Results received: No. Last updated: 2026-02-16.
Decision dates by country: HU: 2024-06-14, NL: 2024-06-12, BE: 2024-06-12, DE: 2024-06-14, PL: 2024-06-14, FR: 2024-06-17, ES: 2024-06-13, PT: 2024-06-12, IT: 2024-06-17

Condition(s): EGFR-mutated locally advanced or metastatic Non Small Cell Lung Cancer
Product: TAGRISSO 80 mg film-coated tablets, TAGRISSO 40 mg film-coated tablets, placebo capsule G065, placebo capsule G040, JNJ-61186372, JNJ-73841937, JNJ-73841937-ZCY Placebo Oral Film-Coated Tablet

Primary endpoint: PFS according to RECIST v1.1 by blinded independent central review

Source: https://euclinicaltrials.eu/ctis-public/view/2023-506576-27-00